EU clinical trial 2024-514746-36-00: Phase 1 dose-escalation trial of OMTX705, an anti-fibroblast activation protein antibody-drug conjugate, as single agent and in combination with anti-PD-1 or pazopanib in patients with advanced solid tumors
Protocol code: OMTX705-001
Sponsor: Oncomatryx Biopharma S.L. (Pharmaceutical company). Phase: Human Pharmacology (Phase I)- First administration to humans. Countries: Spain (ongoing, recruiting).
Therapeutic area(s): Diseases [C] - Neoplasms [C04]
Gender: Female, Male. Age: 18-64 years, 65+ years. Enrolment: 113.
Status: Ongoing, recruiting. Start date (EU): 2022-10-20. Decision date: 2024-07-01. Results received: No. Last updated: 2026-04-22.

Condition(s): Selected tumor indications that are known to express FAP (Fibroblast activation protein) either on tumor stroma CAFs (Cancer-associated fibroblasts) (carcinomas) or on tumor cells (leiomyosarcomas and other sarcomas).

Source: https://euclinicaltrials.eu/ctis-public/view/2024-514746-36-00